EU clinical trial 2024-516306-28-00: Interest of Oxytocin as an Adjuvant Treatment of Psycho-educational Measures in Challenging Behaviors in Children With Autism Spectrum Disorders and Moderate to Severe Intellectual Disability: Feasibility and Safety Study. (OT-DEFI)
Protocol code: RC31/19/0500
Sponsor: Centre Hospitalier Universitaire De Toulouse (Hospital/Clinic/Other health care facility). Phase: Phase II and Phase III (Integrated). Countries: France (temporarily halted).
Therapeutic area(s): Psychiatry and Psychology [F] - Behavior and Behavior Mechanisms [F01]
Gender: Female, Male. Age: 0-17 years. Enrolment: 30.
Status: Temporarily halted. Start date (EU): 2025-02-12. Decision date: 2024-09-10. Results received: No. Last updated: 2025-08-19.

Condition(s): Autism with Spectrum Disorders and Moderate to Severe Intellectual Disability
Product: SODIUM CHLORIDE, OXYTOCIN

Primary endpoint: The results will be considered positive if this percentage is greater than or equal to 80%, with a lower limit of the confidence interval of this estimate beyond 61.4%.
Endpoint(s): Precise statement of the reasons for a possible interruption of the protocol, Qualitative assessment by caregivers and parents of the heaviness of implementing the protocol through semi-directive qualitative and quantitative interviews, - Results of the questionnaires

Source: https://euclinicaltrials.eu/ctis-public/view/2024-516306-28-00